EU clinical trial 2024-515947-49-00: Bioequivalence of Ruxolitinib 20 mg Tablets in Healthy Participants Under Fasting Conditions.
Protocol code: BLCL-RUX-EU-01
Sponsor: Bluepharma Industria Farmaceutica S.A. (Pharmaceutical company). Phase: Human Pharmacology (Phase I)- Bioequivalence Study. Countries: Portugal (ended).
Therapeutic area(s): Not possible to specify
Gender: Female, Male. Age: 18-64 years. Enrolment: 28.
Status: Ended. Start date (EU): 2024-10-07. End date (EU): 2024-11-12. Decision date: 2024-09-27. Results received: No. Last updated: 2024-09-27.

Condition(s): No medical condition.

Source: https://euclinicaltrials.eu/ctis-public/view/2024-515947-49-00